EU clinical trial 2023-505540-19-00: An Open-Label Extension Study to Assess the Safety, Tolerability, and Effectiveness of the Long-Term use of Treprostinil Palmitil Inhalation Powder in Participants with Pulmonary Hypertension Associated with Interstitial Lung Disease
Protocol code: INS1009-212
Sponsor: Insmed Inc. (Pharmaceutical company). Phase: Phase II and Phase III (Integrated). Countries: Spain (ended), Italy (ended), Germany (ended), Belgium (ended).
Therapeutic area(s): Diseases [C] - Respiratory Tract Diseases [C08]
Gender: Female, Male. Age: 18-64 years, 65+ years. Enrolment: 27.
Status: Ended. Start date (EU): 2023-04-24. End date (EU): 2026-04-01. Decision date: 2024-04-26. Results received: No. Last updated: 2026-05-04.
Decision dates by country: ES: 2024-04-26, DE: 2024-04-30, BE: 2024-04-29, IT: 2024-05-02

Condition(s): Pulmonary Hypertension Associated with Interstitial Lung Disease
Product: Placebo (inhalation powder capsules) containing 1 of 3 dosage strengths of TPIP (80 μg, 160 μg, or 320 μg), TREPROSTINIL PALMITIL INHALATION POWDER

Primary endpoint: Frequency and severity of TEAEs during the study.
Endpoint(s): Change from pre-OLE baseline* to Month 6, Month 12, Month 18, and Month 24 in 6MWD (absolute and relative)., Change from pre-OLE baseline* to Month 6, Month 12, Month 18, and Month 24 in FVC, FVC%, FEV1, FEV1%, and FEF25-75% (absolute and relative)., Change from pre-OLE baseline* to Month 6, Month 12, Month 18, and Month 24 in the concentration of NT-proBNP in blood., Change from pre-OLE baseline* to Month 12 and Month 24 in DLCO (absolute and relative)., Annualized rate of clinical worsening events. Clinical worsening is defined as one of the following: ---Hospitalization due to a cardiopulmonary indication ---Lung transplantation ---Death from any cause ---Decrease in 6MWD ≥ 15% from baseline, directly related to disease under study, at 2 consecutive visits at least 24 hours apart ---Need for additional PH therapy., Annualized clinical worsening event rate defined as the total number of clinical worsening events that occurred during the treatment period divided by the total number of participant-years during the treatment period., Annualized rate of occurrence of AE-ILDs., Change from OLE baseline in the K-BILD and EQ-5D-5L questionnaire scores at Month 6, Month 12, Month 18, and Month 24., Plasma concentration levels of TP and TRE.

Source: https://euclinicaltrials.eu/ctis-public/view/2023-505540-19-00